EU clinical trial 2022-502647-35-00: A Phase 2b Randomized, Double-Blind Placebo-Controlled, Multicenter Study to Evaluate the Efficacy and Safety of Efinopegdutide (MK-6024) in Adults with Precirrhotic Nonalcoholic Steatohepatitis
Protocol code: MK-6024-013
Sponsor: Merck Sharp & Dohme LLC (Pharmaceutical company). Phase: Therapeutic exploratory (Phase II). Countries: Spain (ended), Belgium (ended), Austria (ended), Czechia (ended), Portugal (ended), Italy (ended), France (ended), Hungary (ended).
Therapeutic area(s): Diseases [C] - Nutritional and Metabolic Diseases [C18]
Gender: Female, Male. Age: 18-64 years, 65+ years. Enrolment: 67.
Status: Ended. Start date (EU): 2023-09-01. End date (EU): 2025-12-29. End date: 2025-12-30. Decision date: 2023-08-21. Results received: No. Last updated: 2025-12-10.
Decision dates by country: AT: 2023-08-21, IT: 2023-08-23, CZ: 2023-08-23, BE: 2023-08-21, HU: 2023-08-28, PT: 2023-08-21, FR: 2023-08-25, ES: 2023-08-22

Condition(s): Non-alcoholic steatohepatitis
Product: efinopegdutide, SEMAGLUTIDE, efinopegdutide, SEMAGLUTIDE, SEMAGLUTIDE, SEMAGLUTIDE, efinopegdutide, efinopegdutide, MK-6024_PBO_0.5mL, SEMAGLUTIDE

Primary endpoint: Percentage of Participants With Nonalcoholic Steatohepatitis (NASH) Resolution Without Worsening of Fibrosis at Week 52, Percentage of Participants Who Experienced an Adverse Event (AE), Percentage of Participants Who Discontinuing Study Medication Due to an AE
Endpoint(s): Percentage of Participants With ≥1 Stage Improvement in Fibrosis Without Worsening of Steatohepatitis At Week 52, Change from Baseline in Body Weight At Week 52

Source: https://euclinicaltrials.eu/ctis-public/view/2022-502647-35-00